EU clinical trial 2024-517653-27-00: A Phase 2, Open-label, Multi-cohort Study to Assess the Efficacy and Safety of ASP5541 in Participants with Advanced Prostate Cancer
Protocol code: 5541-CL-0201
Sponsor: Astellas Pharma Global Development Inc. (Pharmaceutical company). Phase: Therapeutic exploratory (Phase II). Countries: Italy (ongoing, recruiting), Poland (authorised, recruitment pending), Spain (ongoing, recruiting), France (ongoing, recruiting), Germany (ongoing, recruiting).
Therapeutic area(s): Diseases [C] - Neoplasms [C04]
Gender: Male. Age: 18-64 years, 65+ years. Enrolment: 89.
Start date (EU): 2025-12-17. Decision date: 2025-10-22. Results received: No. Last updated: 2026-07-30.
Decision dates by country: FR: 2025-10-27, IT: 2025-10-22, PL: 2025-10-26, ES: 2025-10-24, DE: 2025-10-23

Condition(s): Prostate Cancer
Product: ABIRATERONE ACETATE, PREDNISONE, PREDNISOLONE, ASP5541, ABIRATERONE ACETATE

Primary endpoint: • Proportion of ARPI-naïve mCRPC participants with PSA decline ≥ 90% from baseline (Cohort 1), • Rates of no mineralocorticoid toxicity, defined as experiencing neither Grade ≥ 1 hypokalemia nor Grade ≥ 2 hypertension (Cohort 2 safety-run in), • Proportion of mHSPC participants with PSA ≤ 0.2 ng/mL at 8 months (Cohort 2), • dose-limiting toxicities (DLTs), AEs, serious Adverse Events (SAEs), laboratory results (including chemistry, hematology and urinalysis), electrocardiograms (ECGs), vital signs, physical examinations and ECOG performance status scores (Cohort 3)
Endpoint(s): • Radiographic progression-free survival (rPFS), defined as the time from date of randomization/first dose date until the date of radiological progressive disease (PD) per RECIST v1.1 and PCWG3 as determined by investigator or death from any cause • Prostate-specific antigen (PSA) decline ≥ 50% from baseline • PSA decline ≥ 90% from baseline (Cohorts 2 and 3 only), • PSA undetectable rate (≤ 0.2 ng/mL) (Cohorts 1 and 3 only) • PSA undetectable rate (≤ 0.02 ng/mL) • Time to PSA progression per PCWG3 criteria • Objective response rate per RECIST v1.1 for soft tissue disease and PCWG3 for bone disease • Duration of response per RECIST v1.1 for soft tissue disease and PCWG3 for bone disease, • Best overall response per RECIST v1.1 for soft tissue disease and PCWG3 for bone disease, • AEs, SAEs, laboratory results (including chemistry, hematology, urinalysis • spot urine potassium and creatinine (Cohort 2 only) • ECGs, vital signs, physical examinations and ECOG performance status scores (Cohorts 1 + 2 only), • Testosterone suppression to ≤ 1 ng/dL, or achieves a ≥ 90% reduction from baseline level • Mean testosterone values by time point • Median time to testosterone suppression of level ≤ 1 ng/dL, Time to pain progression defined using pain scores from the BPI-SF and opiate analgesic use.

Source: https://euclinicaltrials.eu/ctis-public/view/2024-517653-27-00